EU clinical trial 2024-511711-21-00: ChemoRadiotherapy with Or Without surgery followed by consolidation Durvalumab (CROWD): a phase IV feasibility trial
Sponsor: Amsterdam UMC Stichting (Hospital/Clinic/Other health care facility). Phase: Therapeutic use (Phase IV). Countries: Netherlands (ongoing, recruiting).
Therapeutic area(s): Diseases [C] - Neoplasms [C04]; Diseases [C] - Respiratory Tract Diseases [C08]
Gender: Female, Male. Age: 18-64 years, 65+ years. Enrolment: 38.
Status: Ongoing, recruiting. Start date (EU): 2024-12-16. Decision date: 2024-06-12. Results received: No. Last updated: 2024-12-12.

Condition(s): Stage III non-small cell lung cancer
Product: IMFINZI 50 mg/mL concentrate for solution for infusion.

Primary endpoint: Safety defined as the rates of severe surgical morbidity and mortality (Clavien-Dindo grade 3-5) and the percentage of patients with treatment-related adverse events (Gr III-V) within 90-days of surgery, Number of patients able to proceed to durvalumab consolidation after surgery
Endpoint(s): Rate of complete surgical resection (R0), DFS in 2 years, defined from the day of surgery

Source: https://euclinicaltrials.eu/ctis-public/view/2024-511711-21-00